EU clinical trial 2024-512269-14-00: MEthotrexate versus TOcilizumab for treatment of GIant cell Arteritis: a multicenter, randomized, controlled trial
Protocol code: METOGiA
Sponsor: Centre Hospitalier Universitaire De Dijon (Hospital/Clinic/Other health care facility). Phase: Therapeutic confirmatory (Phase III). Countries: France (ongoing, recruitment ended).
Therapeutic area(s): Diseases [C] - Immune System Diseases [C20]
Gender: Female, Male. Age: 18-64 years, 65+ years. Enrolment: 230.
Status: Ongoing, recruitment ended. Start date (EU): 2020-01-27. Decision date: 2024-03-20. Results received: No. Last updated: 2026-04-20.

Condition(s): GIant cell Arteritis
Product: RoActemra 162 mg solution for injection in pre-filled syringe., FOLIC ACID, CORTANCYL 5 mg, comprimé sécable, METHOTREXATE, CORTANCYL 1 mg, comprimé, CORTANCYL 20 mg, comprimé sécable

Primary endpoint: Percentage of patients alive without relapse after initial remission or deviation from the scheduled regimen of prednisone at week 78 (W78).
Endpoint(s): Percentage of patients alive without relapse after initial remission or deviation from the scheduled regimen of prednisone at W52 and 104, Number of patients needed to treat to avoid 1 relapse at W52, 78 and 104, and will be calculated as 1/ absolute risk reduction, that is the difference between the relapse rate in TCZ group and the relapse rate in the MTX group., Percentage of patients in remission without prednisone at W52, 78, 104 and 156, Percentage of patients in remission with prednisone ≤5 mg/day at W52, 78, 104 and 156, Cumulative dose of prednisone at W52, 78, 104 and 156, Quality of life measured by HAQ and SF36 at W 28, 52, 104 and 156, Tiredness measured by FACIT-Fatigue at W28, 52, 104 and 156, Time to relapse or deviation from the scheduled regimen of prednisone, Frequency and type of side effects within 3 years after inclusion, Frequency of GCrelated side effects within 3 years after inclusion, Incremental costs between the two strategies at W52 and W78, Marginal costs of both strategies between W52 and W78, Percentage of Th1 (CD4+IFN-γ+), Th17 (CD4+IL-17+) and Treg (CD4+CD25highFoxP3+) cells among total CD4+ T cells and levels of expression of IL-6R and Gp130 by CD4+ T cells, measured by flow cytometry at W0, W12, W28, W52, W78 and in case of relapse (limited to 5 centers), Serum concentrations of IL-6, soluble IL-6R and soluble gp130 by Luminex at W0, W12, W28, W52, W78 and in case of relapse.

Source: https://euclinicaltrials.eu/ctis-public/view/2024-512269-14-00